EU clinical trial 2024-513960-24-00: Effects of ozanimod on myelin dynamics and neurodegeneration in patients with relapsingremitting multiple sclerosis: correlation with disease activity, cognition, fatigue,depression and quality of life
Sponsor: Ospedale San Raffaele S.r.l. (Hospital/Clinic/Other health care facility). Phase: Therapeutic use (Phase IV). Countries: Italy (ongoing, recruiting).
Therapeutic area(s): Diseases [C] - Nervous System Diseases [C10]
Gender: Female, Male. Age: 18-64 years. Enrolment: 30.
Status: Ongoing, recruiting. Start date (EU): 2022-06-22. Decision date: 2024-07-01. Results received: No. Last updated: 2026-06-24.

Condition(s): Multiple sclerosis patients in relapse and remission form
Product: Ozanimod HCl

Primary endpoint: The primary endpoints of this study are to assess, in RRMS patients treated with ozanimod, the changes from baseline over 2 years of: • Global brain atrophy (i.e., percent brain volume change [PBVC]); • Regional GM volume; • Regional WM volume; • Thalamic volume; • Cortical volume.

Source: https://euclinicaltrials.eu/ctis-public/view/2024-513960-24-00